EU clinical trial 2022-503005-38-00: A Randomized, Double-Blind, Placebo-Controlled, Multiple Dose, Multicenter Phase 2 Induction Study with Long-Term Extension to Evaluate the Clinical Activity and Safety of Oral NX-13 in Participants with Moderate to Severe Ulcerative Colitis
Protocol code: NX-13-201/M25-484
Sponsor: Landos Biopharma Inc. (Pharmaceutical company). Phase: Therapeutic exploratory (Phase II). Countries: Belgium (ended), Poland (ended), Italy (ended).
Therapeutic area(s): Diseases [C] - Digestive System Diseases [C06]
Gender: Female, Male. Age: 18-64 years, 65+ years. Enrolment: 87.
Status: Ended. Start date (EU): 2023-12-04. End date (EU): 2025-04-08. End date: 2025-05-30. Decision date: 2023-08-16. Results received: Yes. Last updated: 2025-04-18.
Decision dates by country: BE: 2023-08-16, PL: 2023-08-17, IT: 2023-08-16

Condition(s): Ulcerative Colitis
Product: NX-13 Matching Placebo, NX-13

Primary endpoint: Change from baseline in Modified Mayo Score (MMS) at Week 12
Endpoint(s): Safety and tolerability - Proportion of participants with TEAEs in induction period - Proportion of participants with SAEs in induction period - Change from baseline in clinical laboratory results, vital signs, and ECGs over time in induction period, Clinical remission - Proportion of participants with MMS ≤2 at Week 12, Clinical response - Proportion of participants with ≥2 points and ≥30% decrease from baseline in MMS with ≥1 point decrease in rectal bleeding subscore RBS or RBS ≤1 at Week 12, Endoscopic response - Proportion of participants with endoscopic subscore ES ≤1 at Week 12, Endoscopic remission - Proportion of participants with endoscopic subscore ES = 0 at Week 12, Endoscopic-histologic mucosal improvement - Proportion of participants with ES ≤1 and Geboes score <2.0 at Week 12, Symptomatic remission - Proportion of participants with RBS = 0 and (i) stool frequency subscore SFS = 0 or (ii) SFS = 1 with baseline SFS ≥2, at Week 12

Source: https://euclinicaltrials.eu/ctis-public/view/2022-503005-38-00